EU clinical trial 2023-507354-32-00: A Study to Learn How Different Amounts and Forms of the Study Intervention Called PF-07899895 are Tolerated and Act in the Body of Healthy Adults
Protocol code: C5471001
Sponsor: Pfizer Inc. (Pharmaceutical company). Phase: Human Pharmacology (Phase I)- First administration to humans. Countries: Belgium (ended).
Therapeutic area(s): Diseases [C] - Digestive System Diseases [C06]
Gender: Female, Male. Age: 18-64 years, 65+ years. Enrolment: 55.
Status: Ended. Start date (EU): 2024-09-09. End date (EU): 2025-10-24. End date: 2025-10-25. Decision date: 2023-10-31. Results received: No. Last updated: 2025-06-27.

Condition(s): Ulcerative Colitis

Source: https://euclinicaltrials.eu/ctis-public/view/2023-507354-32-00